EU clinical trial 2025-523400-72-00: A Phase 2, Randomized, Double-blind, Controlled Study to Evaluate the Safety and Efficacy of VX‑828/Deutivacaftor With and Without Tezacaftor in Subjects Aged 18 Years and Older With Cystic Fibrosis
Protocol code: VX25-828-101
Sponsor: Vertex Pharmaceuticals Inc. (Pharmaceutical company). Phase: Therapeutic exploratory (Phase II). Countries: Spain (authorised, recruitment pending), Sweden (authorised, recruitment pending), Germany (authorised, recruitment pending), Italy (authorised, recruitment pending), Belgium (authorised, recruitment pending), Czechia (authorised, recruitment pending), Ireland (authorised, recruitment pending), Portugal (authorised, recruitment pending), Netherlands (authorised, recruitment pending), France (authorised, recruitment pending), Denmark (authorised, recruitment pending).
Therapeutic area(s): Diseases [C] - Congenital, Hereditary, and Neonatal Diseases and Abnormalities [C16]; Diseases [C] - Respiratory Tract Diseases [C08]
Gender: Female, Male. Age: 18-64 years, 65+ years. Enrolment: 80.
Status: Authorised, recruitment pending. Decision date: 2026-05-29. Results received: No. Last updated: 2026-06-10.
Decision dates by country: BE: 2026-05-29, CZ: 2026-05-29, DK: 2026-05-29, FR: 2026-05-29, DE: 2026-06-01, IE: 2026-05-29, IT: 2026-05-29, PT: 2026-06-01, ES: 2026-06-02, SE: 2026-06-01, NL: 2026-05-29

Condition(s): Cystic fibrosis

Primary endpoint: Safety and tolerability, based on the assessment of adverse events (AEs), laboratory test results, standard 12 lead ECGs, and vital signs, Absolute change in sweat chloride (SwCl) concentrations from baseline through Day 28
Endpoint(s): PK parameters of VX 828, TEZ, D IVA, and their respective metabolite(s), Absolute change in percent predicted forced expiratory volume in 1 second (ppFEV1) from baseline at Day 28, Absolute change in Cystic Fibrosis Questionnaire Revised (CFQ R) respiratory domain (RD) score from baseline at Day 28

Source: https://euclinicaltrials.eu/ctis-public/view/2025-523400-72-00